EU clinical trial 2025-521892-30-00: Comparing high and lOw-dose asPirin with dual anTIplatelet therapy for three Months using prasUgrel and aSpirin following Coronary Artery Bypass Grafting. (OPTIMUS-CABG trial).
Protocol code: 2024/ABM/01/00016
Sponsor: Dolnoslaskie Centrum Chorob Serca Im. Prof. Zbigniewa Religi Medinet Sp. z o.o. (Hospital/Clinic/Other health care facility). Phase: Therapeutic confirmatory (Phase III). Countries: Poland (ongoing, recruiting).
Therapeutic area(s): Diseases [C] - Cardiovascular Diseases [C14]
Gender: Female, Male. Age: 18-64 years, 65+ years. Enrolment: 1703.
Status: Ongoing, recruiting. Start date (EU): 2025-11-24. Decision date: 2025-09-08. Results received: No. Last updated: 2025-11-21.

Condition(s): Primary isolated CABG patients with stable coronary artery disease (chronic coronary syndrome) planned for at least 2 grafts.
Product: ACETYLSALICYLIC ACID, PRASUGREL, ACETYLSALICYLIC ACID

Primary endpoint: The assessment of the proportion of failed grafts is defined according to Fitzgibbon classification (Fitzgibbon Class B + O) 12 months after the randomization following CABG procedure in patients with DAPT with prasugrel (10mg/day) plus ASA (75mg/day) vs high-dose ASA (300mg/d) and DAPT vs low-dose ASA (75mg/day)
Endpoint(s): The assessment of the proportion of failed grafts defined according to Fitzgibbon classification (Fitzgibbon Class B + O) 12 months after the randomization following CABG procedure, in patients receiving high- (300mg/d) vs low-dose ASA (75mg/day)., A safety and efficacy assessment of use of the investigational products, based on the frequency of reported adverse events during the first 6 and 12 and long term follow up months after randomization., a) All-cause mortality at 12 months in the three groups, b) Incidence of myocardial infarction in the three groups, c) Incidence of stroke in the three groups, d) Incidence of repeat revascularization in the three groups, e) Incidence of MACCE (composite mortality, myocardial infarction, stroke and repeat revascularization) at 12 months and beyond 12 months in the three groups, f) Safety of treatment in terms of the incidence of bleeding within 12 months according to the Bleeding Academic Research Consortium (BARC) type 2, 3 or 5 in three groups., g) Quality of life questionnaires evaluated using SAQ 7 and SF 12., Safety of short-term use of the investigational product - assessment until 12 weeks from randomization visit based on the frequency of reported adverse events (AE, AESI, SAE) – type, grading, relationship to prasugrel /ASA.

Source: https://euclinicaltrials.eu/ctis-public/view/2025-521892-30-00